EU clinical trial 2023-510404-44-02: Benzodiazepine stabilizing treatment for patients with benzodiazepine dependence undergoing opioid agonist therapy (BMX-BAR)
Sponsor: Helse Bergen HF (Hospital/Clinic/Other health care facility). Phase: Therapeutic confirmatory (Phase III). Countries: Norway (ongoing, recruiting).
Therapeutic area(s): Psychiatry and Psychology [F] - Mental Disorders [F03]
Gender: Female, Male. Age: 18-64 years. Enrolment: 108.
Status: Ongoing, recruiting. Start date (EU): 2022-10-02. Decision date: 2024-10-25. Results received: No. Last updated: 2025-07-07.

Condition(s): Comorbid dependencies to benzodiazepines and opioids
Product: Valium 5 mg tabletter, Sobril 15 mg tabletter, Sobril 10 mg tabletter, Stesolid, tabletter, Sobril 25 mg tabletter

Primary endpoint: The main endpoint is difference in the illegal index which measures the use of illicit benzodiazepines (as assessed by weekly or monthly supervised urinary tests) at week 24 compared to baseline. The illegal index is defined as the proportion of positive tests and is considered continuous.
Endpoint(s): Differences between the two study arms (baseline compared to week 24 in terms of: Mental health symptoms score using Hopkins symptom check list (SCL-10), Difference between the two study arms (baseline compared to week 24 in terms of: Reaction time (https://www.justpark.com/creative/reaction-time-test/), Differences between the two study arms (baseline compared to week 24 in terms of: Health related quality of life score using EQ-5D-5L, Differences between the two study arms in terms of: Satisfaction with the treatment using Visual Analogue Scale (VAS), Differences between the two study arms in terms of: Retention rate in OAT (days in treatment during the study period), Differences between the two study arms in terms of: Use of other illicit substances (stimulants, opioids, cannabis) and alcohol, based on urinary tests and self-reports, and illicit benzodiazepines based on self-reports, Differences between the two study arms in terms of: Violent behaviour and threats on violence, based on Brøset Violence checklist score (BVC), Differences between the two study arms in terms of: Numbers of non-fatal overdose and death (if any)

Source: https://euclinicaltrials.eu/ctis-public/view/2023-510404-44-02